EU clinical trial 2024-515511-21-00: Multicenter, open label, single arm, phase II study to assess the efficay and safety of enfortumab-vedotin (EV) as a single agent in patients with advanced Neuroendocrine Carcinomas (NEC) refractory or ineligible to platinum-containing chemotherapy
Protocol code: EVNEC
Sponsor: Grupo Espanol De Tumores Neuroendocrinos (Patient organisation/association). Phase: Therapeutic exploratory (Phase II). Countries: Spain (ongoing, recruiting).
Therapeutic area(s): Diseases [C] - Hormonal diseases [C19]
Gender: Female, Male. Age: 18-64 years, 65+ years. Enrolment: 63.
Status: Ongoing, recruiting. Start date (EU): 2025-03-13. Decision date: 2025-02-04. Results received: No. Last updated: 2026-05-27.

Condition(s): Neuroendocrine Carcinoma / G3 Neuroendocrine Tumours
Product: Padcev 20 mg powder for concentrate for solution for infusion, Padcev 30 mg powder for concentrate for solution for infusion

Primary endpoint: Objective response rate (ORR) according to RECIST v1.1.
Endpoint(s): Progression-free survival (PFS): The time from the start of the first dose of the study treatment to the first objective documentation of tumour progression or death from any cause., Duration of response (DOR): The time from the first documentation of confirmed objective response (CR or PR) to the first objective documentation of tumour progression or death due to any reason., Overall survival (OS): The time from the start of the first dose of the study treatment to death due to any reason., Absolute and relative frequencies of patients experiencing adverse events (AEs), patients experiencing serious adverse events (SAEs), patients experiencing adverse reactions (ARs), patients experiencing serious adverse reactions (SARs) and patients experiencing suspected unexpected serious adverse reactions (SUSARs). Absolute frequencies of recorded AEs, recorded SAEs, recorded ARs, recorded SARs and recorded SUSARs., Exploratory variables: Expression levels of nectin-4 determined by immunohistochemistry in the tumour block of the diagnostic biopsy.

Source: https://euclinicaltrials.eu/ctis-public/view/2024-515511-21-00